EU clinical trial 2023-507746-83-00: A Phase 3, Randomized, Double-Blind, Placebo-Controlled, 3-Arm, 3-Period Study to Assess the Efficacy and Safety of a New Formulation of Oral Cladribine Compared with Placebo in Participants with Generalized Myasthenia Gravis (MyClad)
Protocol code: MS700568_0183
Sponsor: Merck Healthcare KGaA (Pharmaceutical company). Phase: Therapeutic confirmatory (Phase III). Countries: Italy (ongoing, recruiting), Poland (ongoing, recruiting), France (ongoing, recruiting), Germany (ongoing, recruiting), Spain (ongoing, recruiting), Belgium (ongoing, recruiting), Bulgaria (ongoing, recruiting), Czechia (ended), Greece (ongoing, recruiting), Hungary (ongoing, recruiting), Romania (temporarily halted), Sweden (ongoing, recruiting).
Therapeutic area(s): Diseases [C] - Nervous System Diseases [C10]
Gender: Female, Male. Age: 18-64 years, 65+ years. Enrolment: 69.
Start date (EU): 2024-11-27. Decision date: 2024-10-09. Results received: No. Last updated: 2026-02-10.
Decision dates by country: CZ: 2025-02-26, PL: 2024-11-18, RO: 2025-03-03, GR: 2025-02-25, BG: 2025-03-27, BE: 2025-02-07, ES: 2024-12-09, IT: 2025-01-16, SE: 2025-01-23, DE: 2024-11-13, HU: 2025-02-27, FR: 2024-11-07

Condition(s): Generalized Myasthenia Gravis
Product: Shingrix powder and suspension for suspension for injection Herpes zoster vaccine (recombinant, adjuvanted), Cladribine Placebo, cladribine

Primary endpoint: Change from Baseline in Myasthenia Gravis - Activities of Daily Living (MG-ADL) Scale Score at Week 24 During the Double-Blind Placebo Controlled (DBPC) Period.
Endpoint(s): Change from Baseline in Quantitative Myasthenia Gravis (QMG) Scale Score at Week 24 during the Double-Blind Placebo Controlled (DBPC) Period., Percentage of MG-ADL Responders at Week 24 during the Double-Blind Placebo Controlled (DBPC) Period., Change from Baseline in Myasthenia Gravis Composite (MGC) Scale Score at Week 24 during the Double-Blind Placebo Controlled (DBPC) Period., Percentage of Quantitative Myasthenia Gravis (QMG) Scale Responders at Week 24 during the Double-Blind Placebo Controlled (DBPC) Period., Change from Baseline in the Revised Myasthenia Gravis Quality of Life – 15 Scale (MG-Qol15r) Score at Week 24 during the Double-Blind Placebo Controlled (DBPC) Period., Time From Initial Cladribine Full Dose Treatment to First Retreatment of Rescue Treatment up to end of Study., Number of Participants With Adverse Events (AEs) and Adverse Events of Special Interest (AESIs)., Number of participants with Adverse Events (AEs) by Severity as per National Cancer Institute Common Terminology Criteria for Adverse Events, version 5.0., Number of Participants with Abnormal Laboratory Variables including Absolute Lymphocyte Count and Vital Signs., Pharmacokinetic (PK) Plasma Concentrations of Cladribine.

Source: https://euclinicaltrials.eu/ctis-public/view/2023-507746-83-00